EU clinical trial 2023-509180-24-00: Pembrolizumab plus Lenvatinib in vulvar cancer patients: The prospective, multi-cohorts and multicentre, phase 2 MITO VULVA-01 study.
Protocol code: MITO VULVA-01
Sponsor: IRCCS Istituto Nazionale Tumori Fondazione Pascale (Hospital/Clinic/Other health care facility). Phase: Therapeutic exploratory (Phase II). Countries: Italy (ongoing, recruiting).
Therapeutic area(s): Diseases [C] - Female Urogenital Diseases and Pregnancy Complications [C13]
Gender: Female. Age: 18-64 years, 65+ years. Enrolment: 80.
Status: Ongoing, recruiting. Start date (EU): 2026-02-12. Decision date: 2025-09-12. Results received: No. Last updated: 2026-08-06.

Condition(s): vulvar cancer
Product: KEYTRUDA 25 mg/mL concentrate for solution for infusion., Lenvatinib, Lenvatinib

Primary endpoint: Objective response rate (ORR) defined as a complete response (CR) or partial response (PR) by the Investigator using RECIST 1.1 criteria, in each single cohort (ORR will be evaluated after 4 cycles in Cohort A patients and on the whole treatment period in Cohort B and C patients), Safety profile of Pembrolizumab plus Lenvatinib according to CTCAE (version 5.0) and PRO-CTCAE questionnaire in the overall study population

Source: https://euclinicaltrials.eu/ctis-public/view/2023-509180-24-00